EU clinical trial 2022-501855-97-00: CC-122 Rollover Study
Protocol code: CA0921000
Sponsor: Celgene Corp. (Pharmaceutical company). Phase: Human Pharmacology (Phase I)- Other. Countries: France (ended), Netherlands (ended).
Therapeutic area(s): Diseases [C] - Neoplasms [C04]
Gender: Female, Male. Age: 18-64 years. Enrolment: 6.
Status: Ended. Start date (EU): 2023-06-29. End date (EU): 2025-06-04. Decision date: 2023-06-12. Results received: No. Last updated: 2024-12-20.
Decision dates by country: NL: 2023-06-12, FR: 2023-06-12

Condition(s): Multiple Myeloma, Follicular Lymphoma, Diffuse Large B-Cell Lymphoma.

Source: https://euclinicaltrials.eu/ctis-public/view/2022-501855-97-00